EU clinical trial 2024-512359-19-00: Phase II clinical trial of Neo-adjuvant chemo/immunotherapy followed by adjuvant treatment depending on the resection status for the treatment of NSCLC patients diagnosed with pancoast tumor. A multicenter exploratory study_DUMAS
Sponsor: Fundacion GECP (Patient organisation/association). Phase: Therapeutic exploratory (Phase II). Countries: Spain (ongoing, recruitment ended).
Therapeutic area(s): Diseases [C] - Neoplasms [C04]
Gender: Female, Male. Age: 18-64 years, 65+ years. Enrolment: 22.
Status: Ongoing, recruitment ended. Start date (EU): 2023-05-12. Decision date: 2024-03-22. Results received: No. Last updated: 2026-04-06.

Condition(s): Resectable Non-small cell lung cancer Pancoast tumor
Product: OPDIVO 10 mg/mL concentrate for solution for infusion.

Primary endpoint: The primary objective is to estimate progression-free survival (PFS) at 24 months from enrollment. The PFS is defined as the time from enrollment to relapse, progression or death, whichever occurred first.
Endpoint(s): 1. Overall survival rate (OS) at 24 months: Overall survival is defined as the time between the date of enrollment and the date of death. OS will be censored on the last date a participant was known to be alive, 2. Complete resection (R0) after induction treatment with chemotherapy plus nivolumab, 3. Objective treatment response rate (ORR), Disease control rate (DCR) and Duration of response (DOR). Systemic ORR, defined as a complete or partial response as determined by the investigator according to RECIST v1.1., 4. Pathological response and percentage of Residual tumor viable (RTV%) in the primary tumor: pathological complete response (pCR) defined as the absence of residual tumor, Major pathological response rate (MPR), defined as number of randomized participants with <10% residual tumor, 5. Treatment safety and tolerability, 6.Study of the prognostic value of basal ctDNA (association of basal levels with PFS and OS) and to assess the minimal residual disease (MRD) in plasma samples, 7. To assess minimal residual disease (MRD) in the baseline tumor sample before treatment

Source: https://euclinicaltrials.eu/ctis-public/view/2024-512359-19-00